EU clinical trial 2025-521802-17-00: RANDOMISED, MULTICENTRE, DOUBLE-BLIND CLINICAL TRIAL TO EVALUATE THE EFFICACY AND SAFETY OF MONTELUKAST VS. PLACEBO IN PATIENTS WITH EROSIVE/INFLAMMATORY OSTEOARTHRITIS OF THE HANDS. MOTHER Study.
Sponsor: Farmalider S.A. (Pharmaceutical company). Phase: Therapeutic confirmatory (Phase III). Countries: Spain (ongoing, recruiting), Italy (authorised, recruitment pending), Portugal (ongoing, recruiting).
Therapeutic area(s): Diseases [C] - Musculoskeletal Diseases [C05]; Diseases [C] - Immune System Diseases [C20]
Gender: Female, Male. Age: 18-64 years, 65+ years. Enrolment: 160.
Start date (EU): 2026-01-30. Decision date: 2025-10-23. Results received: No. Last updated: 2026-07-02.
Decision dates by country: PT: 2025-10-23, IT: 2025-10-27, ES: 2025-10-23

Condition(s): Erosive/inflammatory osteoarthritis of the hands
Product: Montelukast C, Placebo

Primary endpoint: Difference in pain intensity (PID) at rest of the most affected hand with respect to baseline pain at 24 weeks of treatment with Montelukast xx mg, compared to placebo, measured through the VAS.

Source: https://euclinicaltrials.eu/ctis-public/view/2025-521802-17-00